EU clinical trial 2024-510706-86-00: Study evaluating the clinical impact of HDM201 + Pazopanib in patients with P53 wild-type advanced/ metastatic soft tissue sarcomas.
Protocol code: ET20-297
Sponsor: Centre Leon Berard (Hospital/Clinic/Other health care facility). Phase: Phase I and Phase II (Integrated)- Other. Countries: France (ongoing, recruiting).
Therapeutic area(s): Diseases [C] - Neoplasms [C04]
Gender: Female, Male. Age: 18-64 years, 65+ years. Enrolment: 58.
Status: Ongoing, recruiting. Start date (EU): 2022-05-16. Decision date: 2024-11-05. Results received: No. Last updated: 2026-06-08.

Condition(s): Advanced/ metastatic soft tissue sarcomas

Source: https://euclinicaltrials.eu/ctis-public/view/2024-510706-86-00